EU clinical trial 2022-502351-60-00: ETIC-LM_Multicentric single arm phase II study evaluating the Efficacy of association of Tucatinib, capecitabine and Intra-CSF trastuzumab in HER2 amplified breast cancer patients with Leptomeningeal Metastases.
Sponsor: Unicancer (Hospital/Clinic/Other health care facility). Phase: Therapeutic exploratory (Phase II). Countries: France (ongoing, recruiting).
Therapeutic area(s): Diseases [C] - Neoplasms [C04]
Gender: Female, Male. Age: 18-64 years, 65+ years. Enrolment: 30.
Status: Ongoing, recruiting. Start date (EU): 2024-02-22. Decision date: 2023-09-21. Results received: No. Last updated: 2026-03-27.

Condition(s): Patients having a HER2-amplified metastatic breast cancer with evolutive leptomeningeal metastases (LM) requiring intrathecal therapy
Product: TUKYSA 150 mg film-coated tablets, TUKYSA 50 mg film-coated tablets, Xeloda 500 mg film-coated tablets, Xeloda 150 mg film-coated tablets, Herceptin 150 mg powder for concentrate for solution for infusion

Primary endpoint: Efficacy of combination will be evaluated in terms of overall survival rate 12 months (12m-OS) after treatment by tucatinib, capecitabine, and intra-CSF trastuzumab. 12m-OS will be defined as the proportion of patients alive 12 months after treatment initiation.
Endpoint(s): Efficay_Clinical neurological symptoms relief will be defined as complete or partial regression of symptoms associated to LM using NANO scale., Efficacy_Progression-free survivals (PFS, PFS-brain metastases [BM] and PFS-LM) will be defined as the time from treatment initiation (C1D1) to the date of the first documented progression (RECIST v1.1 or RANO-LM for LM and BM) or death due to any cause. Patients who have not progressed at the time of analysis will be censored at the time of their last evaluable assessment._, Efficacy_Overall Survival (OS) will be defined as the time between treatment initiation (C1D1) and death from any cause., Efficay_Quality of life will be assessed using the QLQ-C30 and BN20 questionnaires., Efficacy_CSF response at 4 weeks will be defined by absence of tumor cells in CSF evaluated by the cytologist on minimal 10mL of CSF, fixed within 1h after sampling., Efficacy_Duration of LM response will be defined in responding patients as the delay between first intracranial objective response and progression, using PFS-LM definition., Safety_Tolerance will be assessed using the NCI-CTCAE v5.0 grading scale., Safety_Cognitive troubles will be evaluated using the MOCA (Le Montreal Cognitive Assessment), Ancillary studies_Venous blood samples and cerebrospinal fluid (CSF) (approximately 5 mL) will be collected before intra-CSF traztuzumab injection, from week 2 to week 10, and at week 18 to determine the concentrations of experimental treatment. Concentration will be determine using high performance liquid chromatography (HPLC)., Ancillary studies_Genomic alteration will be assessed using tumors cells from collected CSF sample. DNA will be extracted from cell to perform array-based comparative genomic hybridization (CGH) and next-generation sequencing (NGS; homemade Illumina pipeline)., Ancillary studies_Droplet digital PCR and CellSearch® will be performed on CSF sample and blood samples for the analysis of HER2 amplification and Circulating Tumor Cells (CTC)

Source: https://euclinicaltrials.eu/ctis-public/view/2022-502351-60-00